EU clinical trial 2022-502948-13-00: A Phase 2, Randomized Study to Evaluate the Optimized Dose, Safety, and Efficacy of Livmoniplimab in Combination with Budigalimab for locally advanced or Metastatic Hepatocellular Carcinoma patients who have progressed after an approved immune checkpoint inhibitor containing regimen in First-Line HCC
Protocol code: M24-147
Sponsor: Abbvie Deutschland GmbH & Co. KG (Pharmaceutical company). Phase: Therapeutic exploratory (Phase II). Countries: France (ongoing, recruitment ended), Spain (ongoing, recruitment ended), Italy (ongoing, recruitment ended).
Therapeutic area(s): Diseases [C] - Immune System Diseases [C20]
Gender: Female, Male. Age: 18-64 years, 65+ years. Enrolment: 63.
Status: Ongoing, recruitment ended. Start date (EU): 2024-03-01. Decision date: 2023-11-15. Results received: No. Last updated: 2026-07-17.
Decision dates by country: IT: 2023-11-15, ES: 2023-11-15, FR: 2023-11-17

Condition(s): Hepatocellular Carcinoma
Product: Kisplyx 4 mg hard capsules, Sorafenib STADA 200 mg Filmtabletten, Budigalimab, Livmoniplimab

Primary endpoint: The primary endpoint is the BOR of confirmed CR or confirmed PR per RECIST 1.1 as determined by investigators at any time prior to subsequent anticancer therapy.
Endpoint(s): The secondary endpoints are DoR by investigators, PFS by investigators, and OS., PFS by investigators: The time from randomization until the first documentation of progressive disease according to RECIST 1.1 as determined by investigators or death from any cause, whichever occurs first., OS: The time from randomization until death from any cause.

Source: https://euclinicaltrials.eu/ctis-public/view/2022-502948-13-00